EU clinical trial 2023-506350-21-00: L-UteCIN : Interest of adjuvant chemotherapy in patients with CINSARC high-risk localized resected uterine leiomyosarcoma
Protocol code: UC-SAR-2212_L-UteCIN
Sponsor: Unicancer (Hospital/Clinic/Other health care facility). Phase: Therapeutic exploratory (Phase II). Countries: France (ongoing, recruiting).
Therapeutic area(s): Diseases [C] - Neoplasms [C04]
Gender: Female. Age: 18-64 years, 65+ years. Enrolment: 198.
Status: Ongoing, recruiting. Start date (EU): 2025-01-06. Decision date: 2024-07-26. Results received: No. Last updated: 2026-07-09.

Condition(s): Localized, resected, FIGO stage I (2018 classification), uterine leiomyosarcoma
Product: DOXORUBICINE ARROW 2 mg/ml, solution pour perfusion, Yondelis 1 mg powder for concentrate for solution for infusion

Primary endpoint: The primary endpoint is the RFS, which is defined as the time from the date of randomization assignment to the date of first disease recurrence/relapse (local/regional recurrence and/or distant metastasis) or death from any cause whichever comes first. Patients still alive at the time of analysis (including lost to follow-up) without appearance of relapse or recurrence will be censored at the last disease assessment date.
Endpoint(s): Randomized part : Overall survival (OS) is defined by the time between randomization and death from any cause. Patients still alive at the time of analysis (including lost to follow-up) will be censored at the last known alive date., Randomized part : Metastases-free survival (MFS) is defined by the time between randomization and the appearance of metastatic disease or death from any cause. In case of initial loco-regional relapse, patients will be censored at the date of appearance. Patients still alive at the time of analysis (including lost to follow-up) without appearance of metastatic disease will be censored at the last disease assessment date., Randomized part : Safety and tolerability (NCI-CTCAE v5.0) will be assessed through the incidence of adverse events, treatment-related adverse events, serious adverse events (SAEs) and death., Randomized part : Quality of life (QoL) will be assessed by the European Organization for Research and Treatment of Cancer (EORTC) QLQ-C30 questionnaire. A deterioration of scores for five-targeted dimensions: pain, physical and emotional functioning, fatigue, and appetite will be compared between the two treatment arms, while other dimensions will be regarded as exploratory., Prognostic value : The RFS is defined as the time from the date of inclusion assignment to the date of first disease recurrence/relapse (local/regional recurrence and/or distant metastasis) or death from any cause, whichever comes first. Patients still alive at the time of analysis (including lost to followup) without appearance of relapse or recurrence will be censored at the last disease assessment date., Prognostic value : Overall survival (OS) is defined by the time between inclusion and death from any cause. Patients still alive at the time of analysis (including lost to follow-up) will be censored at the last known alive date., Prognostic value : Metastases-free survival (MFS) is defined by the time between inclusion and the appearance of metastatic disease or death from any cause. In case of initial loco-regional relapse, patients will be censored at the date of appearance. Patients still alive at the time of analysis (including lost to follow-up) without appearance of metastatic disease will be censored at the last disease assessment date.

Source: https://euclinicaltrials.eu/ctis-public/view/2023-506350-21-00